EU clinical trial 2024-514337-38-00: A Phase 3, Randomized, Double-blind, Placebo-controlled Study of Adeno-associated Virus Serotype 8 (AAV8)-mediated Gene Transfer of Human Ornithine Transcarbamylase (OTC) in Patients with Late-onset OTC Deficiency
Protocol code: DTX301-CL301
Sponsor: Ultragenyx Pharmaceutical Inc. (Pharmaceutical company). Phase: Therapeutic confirmatory (Phase III). Countries: Spain (ongoing, recruitment ended), Netherlands (ongoing, recruitment ended), Italy (ended), Portugal (ongoing, recruitment ended), France (ongoing, recruitment ended), Germany (ongoing, recruitment ended).
Therapeutic area(s): Diseases [C] - Congenital, Hereditary, and Neonatal Diseases and Abnormalities [C16]; Diseases [C] - Nutritional and Metabolic Diseases [C18]
Gender: Female, Male. Age: 0-17 years, 18-64 years, 65+ years. Enrolment: 32.
Start date (EU): 2023-01-24. Decision date: 2024-09-30. Results received: No. Last updated: 2025-11-25.
Decision dates by country: IT: 2024-10-14, ES: 2024-09-30, NL: 2024-10-01, FR: 2024-10-04, DE: 2024-10-07, PT: 2024-10-03

Condition(s): Late-onset Ornithine transcarbamylase (OTC) deficiency
Product: Prednisolon STADA® 5 mg Tabletten, Prednisolone placebo hard capsule and tablet, Normal Saline, Prednisolon STADA® 10 mg Tabletten, [1-13C]SODIUM ACETATE, Avalotcagene ontaparvovec

Primary endpoint: Plasma ammonia as measured by 24-hour ammonia (AUC0-24) at Week 36, Complete Responder rate at the final study visit after DTX301 exposure
Endpoint(s): Percentage of Complete Responders or Responders after DTX301 exposure, Annualized event rate of HACs pre-DTX301 exposure vs post-DTX301 exposure, Annualized event Rate of ICEs pre-DTX301 exposure vs post-DTX301 exposure, Change from baseline to Week 36 in plasma ammonia (AUC0-24), Change in plasma ammonia (AUC0-24) after DTX301 exposure, Percentage of patients who have achieved complete management response (CMR) or management response (MR) after DTX301 exposure, Change in baseline disease management (dietary protein and total scavenger medication use) with plasma ammonia (AUC0-24) (comparison between those with a reduction of elevated plasma ammonia [AUC0-24] at baseline vs those without), Incidence of TEAEs, TESAEs, treatment-related TEAEs, treatment-related TESAEs, and AESIs, Incidence of anti-OTC antibodies, Long-term durability of response based upon number of Complete Responders or Responders that have ≥ 2 consecutive visits as a Complete Responder or Responder and do not return to a lower Responder status for > 1 consecutive visit, Change in plasma ammonia as measured by 24-hour ammonia (AUC0-24) at Week 64 PEA-2 for patients who have an elevated ammonia AUC0-24 at baseline

Source: https://euclinicaltrials.eu/ctis-public/view/2024-514337-38-00